EU clinical trial 2023-504478-39-00: EORTC-2014-HNCG: PROLoNg: Pembrolizumab and Radiotherapy for OLigometastatic squamous cell carcinoma of the head and Neck: a randomized phase III study
Protocol code: 2014-HNCG
Sponsor: European Organisation For Research And Treatment Of Cancer (Patient organisation/association). Phase: Therapeutic confirmatory (Phase III). Countries: Italy (ongoing, recruiting), Belgium (ongoing, recruiting), Spain (ongoing, recruiting).
Therapeutic area(s): Diseases [C] - Neoplasms [C04]
Gender: Female, Male. Age: 18-64 years, 65+ years. Enrolment: 160.
Status: Ongoing, recruiting. Start date (EU): 2025-05-23. Decision date: 2024-11-12. Results received: No. Last updated: 2025-12-26.
Decision dates by country: IT: 2024-11-14, ES: 2024-11-18, BE: 2024-11-12

Condition(s): Squamous cell carcinoma of head and neck
Product: PEMBROLIZUMAB

Primary endpoint: Progression-free survival by RECIST 1.1, as assessed by the local investigator
Endpoint(s): Overall survival, Disease-specific survival, Time to disease progression, Time to development of new metastatic lesions, Time to progression in oligometastatic lesions initially present at enrolment, Adverse events according to CTCAE version 5.0, Patient reported tolerability: dyspnoea, pain, insomnia, fatigue, appetite loss, nausea, constipation, diarrhoea, anxiety, coughing, dry mouth, neurological problems, trismus, problems with senses, problems with shoulder, skin problems, swallowing, swelling in neck, problems with speech, problems with teeth and weight loss scales as measured by the QLQ-C15-PAL and EORTC IL243 questionnaires, Patient reported benefit: physical functioning and burden of illness scales as measured by the QLQ-C15-PAL and EORTC IL243

Source: https://euclinicaltrials.eu/ctis-public/view/2023-504478-39-00